EU clinical trial 2023-507843-12-01: Cannabidiol in refractory childhood epilepsy, a personalized high-quality approach
Sponsor: Universitair Medisch Centrum Utrecht (Hospital/Clinic/Other health care facility). Phase: Therapeutic confirmatory (Phase III). Countries: Netherlands (authorised, recruiting).
Therapeutic area(s): Diseases [C] - Nervous System Diseases [C10]
Gender: Female, Male. Age: 0-17 years. Enrolment: 50.
Status: Authorised, recruiting. Start date (EU): 2025-01-24. Decision date: 2024-08-05. Results received: No. Last updated: 2025-12-31.

Condition(s): Refractory Epilepsy
Product: Placebo cannabis oil. Components: cannabis granulated flos after (ethanol) extraction of cannabinoids; arachidis oleum raffinatum., TA-CBD 10

Primary endpoint: Change from baseline in daily seizure frequency during placebo periods compared to the change from baseline in daily seizure frequency during active treatment periods.
Endpoint(s): Change in score from baseline during placebo versus CBD treatment of: Quality of Life in Childhood Epilepsy (QoLCE-55); Global Assessment of Severity of Epilepsy (GASE); Clinical Global Impression of Change (CGI-C); Aberrant Behavior Checklist (ABC); Vineland Adaptive Behavior Score III (VABS-III); Sleep Disturbances Scale for Children (SDSC); Goal attainment scaling (GAS)., Number of (serious) adverse events, Clinical characteristics including: age; gender; epilepsy characteristics; etiology; comorbidity; co-medication., Measurements of neuronal excitability, measured on EEG and TMS-EMG: assessment of epileptic discharges on EEG; assessment of background activity on EEG; measurement of resting motor threshold on TMS-EMG; measurement of cortical silent period (CSP) on TMS-EMG., Pharmacogenetic assessment of CYP-enzymes such as CYP2C19, CYP2C9, and CYP3A4., Change in productivity loss measured by iMTA Productivity Cost Questionnaire; change in healthcare resources used measured by iMTA Treatment Inventory of Costs in Patients with psychiatric disorders for Children; change in health related quality of life measured by EuroQol Five-Dimensional Questionnaire, Youth version

Source: https://euclinicaltrials.eu/ctis-public/view/2023-507843-12-01